EU clinical trial 2023-508104-38-00: A Phase 2, Multicenter, Placebo-Controlled, Randomized, Double-Blind, 48-Week Study to Evaluate the Efficacy and Safety of Combination Therapy of K-877-ER and CSG452 in Patients with Noncirrhotic Nonalcoholic Steatohepatitis (NASH) with Liver Fibrosis
Protocol code: K-001-201
Sponsor: Kowa Research Institute Inc. (Pharmaceutical company). Phase: Therapeutic exploratory (Phase II). Countries: Spain (ended), Bulgaria (ended).
Therapeutic area(s): Phenomena and Processes [G] - Metabolism [G03]
Gender: Female, Male. Age: 18-64 years. Enrolment: 16.
Status: Ended. Start date (EU): 2023-02-16. End date (EU): 2026-02-12. End date: 2026-06-03. Decision date: 2024-07-09. Results received: No. Last updated: 2026-03-24.
Decision dates by country: BG: 2024-07-12, ES: 2024-07-09

Condition(s): Noncirrhotic Nonalcoholic Steatohepatitis (NASH) with Liver Fibrosis
Product: CSG452 (Tofogliflozin) placebo, pemafibrate, K-877 ER (Pemafibrate) placebo, TOFOGLIFLOZIN

Primary endpoint: The primary efficacy endpoint is improvement from Baseline (defined by central reading of a liver biopsy sample obtained at the Baseline Biopsy Visit, or historical biopsy obtained within 24 weeks of randomization) in disease activity and no worsening of liver fibrosis on the NASH Clinical Research Network (CRN) fibrosis score at Week 48. The improvement in disease activity is defined as improvement in NAFLD Activity Score (NAS) >=2 points.
Endpoint(s): Resolution of steatohepatitis on overall histopathological reading and no worsening of liver fibrosis on the NASH CRN fibrosis score at Week 48. Resolution of steatohepatitis is defined as absent fatty liver disease or isolated or simple steatosis without steatohepatitis and a NAS score of 0–1 for inflammation, 0 for ballooning, and any value for steatosis., Improvement from Baseline in liver fibrosis score ≥1 and no worsening of steatohepatitis (defined as no increase in NAS for ballooning, inflammation, or steatosis) at Week 48, Both resolution of steatohepatitis and improvement in liver fibrosis score ≥1 from Baseline at Week 48, Resolution of steatohepatitis on overall histopathological reading at Week 48., Improvement from Baseline in liver fibrosis score ≥1 at Week 48, Improvement from Baseline in each of the NAS components (inflammation, ballooning, and steatosis) ≥1 point at Week 48

Source: https://euclinicaltrials.eu/ctis-public/view/2023-508104-38-00